EU clinical trial 2024-515824-35-01: Efficacy of antibiotic treatment for patients with chronic low back pain and Modic type I changes - randomized placebo-controlled trial
Sponsor: Erasmus Universitair Medisch Centrum Rotterdam (Erasmus MC) (Hospital/Clinic/Other health care facility). Phase: Therapeutic use (Phase IV). Countries: Netherlands (ongoing, recruiting).
Therapeutic area(s): Diseases [C] - Musculoskeletal Diseases [C05]
Gender: Female, Male. Age: 18-64 years. Enrolment: 204.
Status: Ongoing, recruiting. Start date (EU): 2024-12-17. Decision date: 2024-10-18. Results received: No. Last updated: 2026-06-05.

Condition(s): non-specific low back pain
Product: Placebo amoxicillin capsules 500mg, Amoxicillin 500 mg film-coated tablets

Primary endpoint: Pain and disability measured with the Roland Morris Disability Questionnaire (RMDQ)
Endpoint(s): LBP-intensity (0-10 NRS-scale), Leg pain intensity (0-10 NRS-scale), Global perceived effect (7-point Likert scale), Health-related quality of life (PROMIS-GH-10 and EQ-5D-5L), Self-reported number of days with sick leave, Co-interventions (pharmacological and non-pharmacological), Patients’ satisfaction with treatment (7-point Likert scale), Success of blinding (patient and physician), Compliance (pill count), Pain self-efficacy (Pain Self-Efficacy Questionnaire), Sleep (Pittsburgh Sleep Quality Index), Neuropathic pain (PainDETECT), MRI-imaging at 12 months follow-up (to investigate the outcome of the antibiotic treatment on the Modic changes), LBP-related health care costs measured with cost questionnaires (iMCQ and iPCQ)

Source: https://euclinicaltrials.eu/ctis-public/view/2024-515824-35-01